EU clinical trial 2025-523085-24-00: Phase III, Randomized, Open-label, Global, Multicenter Study of Rilvegostomig or Durvalumab in Combination With Chemotherapy as a First-line Treatment for Patients With Advanced Biliary Tract Cancer (ARTEMIDE-Biliary02).
Protocol code: D702NC00001
Sponsor: AstraZeneca AB (Pharmaceutical company). Phase: Therapeutic confirmatory (Phase III). Countries: Germany (ongoing, recruiting), Poland (ongoing, recruiting), Italy (ongoing, recruiting), Belgium (ongoing, recruiting), France (ongoing, recruiting), Netherlands (ongoing, recruiting), Spain (ongoing, recruiting).
Therapeutic area(s): Diseases [C] - Neoplasms [C04]
Gender: Female, Male. Age: 18-64 years, 65+ years. Enrolment: 232.
Status: Ongoing, recruiting. Start date (EU): 2026-04-13. Decision date: 2026-03-23. Results received: No. Last updated: 2026-07-20.
Decision dates by country: BE: 2026-03-23, FR: 2026-03-30, IT: 2026-03-25, ES: 2026-03-25, NL: 2026-03-31, DE: 2026-03-26, PL: 2026-03-27

Condition(s): Biliary Tract Cancer
Product: GEMCITABINE, IMFINZI 50 mg/mL concentrate for solution for infusion, INFLIXIMAB, CISPLATIN, MYCOPHENOLATE MOFETIL, Rilvegostomig

Primary endpoint: Overall survival of Rilvegostomig+Chemotherapy vs Durvalumab+Chemotherapy
Endpoint(s): Progression Free Survival of Rilvegostomig+Chemotherapy vs Durvalumab+Chemotherapy

Source: https://euclinicaltrials.eu/ctis-public/view/2025-523085-24-00